EU clinical trial 2024-513846-13-00: Aspirin in immune thrombocytopenia patients with cardiovascular disease
Protocol code: RC31/19/0509
Sponsor: Centre Hospitalier Universitaire De Toulouse (Hospital/Clinic/Other health care facility). Phase: Phase III and phase IV (Integrated). Countries: France (ended).
Therapeutic area(s): Diseases [C] - Hemic and Lymphatic Diseases [C15]
Gender: Female, Male. Age: 18-64 years, 65+ years. Enrolment: 10.
Status: Ended. Start date (EU): 2023-01-16. End date (EU): 2025-01-15. Decision date: 2024-05-28. Results received: Yes. Last updated: 2024-05-28.

Condition(s): Immune thRombocytopenia
Product: KARDEGIC 75 mg, poudre pour solution buvable en sachet-dose

Primary endpoint: Platelet production of thromboxane B2 (TXB2) 24 hours after a 75 mg aspirin intake
Endpoint(s): Platelet function by light transmission agregometry (LTA) 24 four hours after a 75 mg aspirin intake;, platelet production of TXB2 by lipidomic and platelet function by LTA at H2 and H12 after a75 mg aspirin intake, arterial thromboses identified in the CARMEN registry., Measurement of platelet TXB2 synthesis after platelet stimulation by arachidonic acid at H2 and H12 from a dose of 75 mg of AAS. 12-HETE produced by lymphoxygenase and quantified in the same mass spectrometry profile as TXB2 will also be taken into account.

Source: https://euclinicaltrials.eu/ctis-public/view/2024-513846-13-00